EU clinical trial 2025-522979-29-00: A randomized phase III, global, multicentre, open label clinical trial comparing Venetoclax Azacitidine and Quizartinib vs Venetoclax and Azacitidine in newly diagnosed acute myeloid leukemia patient´s ineligible for standard induction chemotherapy.
Protocol code: VENP-A-QUI
Sponsor: Fundacion PETHEMA (Patient organisation/association). Phase: Therapeutic confirmatory (Phase III). Countries: Spain (ongoing, recruiting).
Therapeutic area(s): Diseases [C] - Neoplasms [C04]
Gender: Female, Male. Age: 18-64 years, 65+ years. Enrolment: 350.
Status: Ongoing, recruiting. Start date (EU): 2026-04-30. Decision date: 2025-12-04. Results received: No. Last updated: 2026-06-26.

Condition(s): Acute myeloid leukemia
Product: Quizartinib, Quizartinib

Primary endpoint: Overall survival (OS)
Endpoint(s): Event-free survival (EFS), Composite CR (CCR) (best response obtained on study), Early mortality (first 30 and 60 days), CR, CRh, and CRi with negative measurable residual disease (MRD) by NGS, CR, CRh, CRi and CCR at 1, 4 and 9 cycles of treatment, Time to CR, CRh, CRi, CCRCR, CRi, MLFS, PR, PD, Relapse-free survival (RFS), Cumulative incidence of relapse (CIR), Duration of response (DoR), Quality of life measurements (from the EuroQoL Group EQ-5D-5L and the EORTC QLQ-C30 instruments), Medical resources during treatement phase, Rates of RBC and platelet transfusion independence, duration of RBC transfusion independence and platelet transfusion independence and platelet and RBC transfusion independence, Minimal residual disease (MRD) by NGS, Separate analyses in secondary AML, CBF, FLT3-ITD, FLT3 other, NPM1, P53, IDH1/IDH2, and subsets

Source: https://euclinicaltrials.eu/ctis-public/view/2025-522979-29-00